EU clinical trial 2023-507286-25-00: VERLEN - Phase II, Open-Label Study evaluating efficacy of Lenalidomide and Tafasitamab combination associated to Rituximab in frontline Diffuse Large B-Cell Lymphoma Patients of 80 y/o or older
Protocol code: VERLEN
Sponsor: LYSARC (Laboratory/Research/Testing facility). Phase: Therapeutic exploratory (Phase II). Countries: France (ongoing, recruitment ended), Belgium (ongoing, recruitment ended).
Therapeutic area(s): Diseases [C] - Hemic and Lymphatic Diseases [C15]
Gender: Female, Male. Age: 65+ years. Enrolment: 45.
Status: Ongoing, recruitment ended. Start date (EU): 2021-12-23. Decision date: 2024-01-10. Results received: No. Last updated: 2026-08-05.
Decision dates by country: BE: 2024-01-15, FR: 2024-01-10

Condition(s): Diffuse Large B-Cell Lymphoma
Product: MabThera 500 mg concentrate for solution for infusion, ONCOVIN 1 mg, solution injectable, PREDNISONE ARROW 20 mg, comprimé sécable, CYCLOPHOSPHAMIDE, MINJUVI 200 mg powder for concentrate for solution for infusion, VINCRISTINE, DOXORUBICIN, Zelvina 20 mg hard capsules, MabThera 1400 mg solution for subcutaneous injection

Primary endpoint: ORR encompasses patients that reach Complete Metabolic Response or Partial Metabolic Response based on investigator disease assessment according to Lugano Response Criteria.
Endpoint(s): Central review of PET-CT according to Lugano Response Criteria, Complete Metabolic response (CMR) rates based on investigator disease assessment and central assessment, Overall Survival (OS), Quality of Life (QoL), Progression Free Survival (PFS), Assess safety of lenalidomide and tafasitamab in the context of patients treated by rituximab

Source: https://euclinicaltrials.eu/ctis-public/view/2023-507286-25-00